EU clinical trial 2024-515092-36-00: An Open-Label Extension and Safety Monitoring Study of Acoramidis (AG10) in Participants with Symptomatic Transthyretin Amyloid Cardiomyopathy Who Completed the Phase 3 ATTRibute-CM Trial (AG10-301)
Protocol code: AG10-304
Sponsor: Eidos Therapeutics Inc. (Pharmaceutical company). Phase: Therapeutic confirmatory (Phase III). Countries: Ireland (ongoing, recruitment ended), Belgium (ongoing, recruitment ended), Denmark (ongoing, recruitment ended), Spain (ongoing, recruitment ended), Portugal (ongoing, recruitment ended), Netherlands (ongoing, recruitment ended), Czechia (ongoing, recruitment ended), Greece (ongoing, recruitment ended), Italy (ongoing, recruitment ended).
Therapeutic area(s): Diseases [C] - Cardiovascular Diseases [C14]
Gender: Female, Male. Age: 18-64 years, 65+ years. Enrolment: 213.
Status: Ongoing, recruitment ended. Start date (EU): 2022-02-14. Decision date: 2024-08-29. Results received: No. Last updated: 2026-05-15.
Decision dates by country: BE: 2024-08-29, CZ: 2024-09-03, DK: 2024-08-30, GR: 2024-09-20, IE: 2024-08-29, IT: 2024-10-16, PT: 2024-09-02, ES: 2024-08-29, NL: 2024-09-02

Condition(s): Symptomatic Transthyretin Amyloid Cardiomyopathy (ATTR-CM)
Product: Acoramidis (AG10)

Primary endpoint: Safety parameters to be assessed: treatment- emergent serious adverse events (SAEs) and adverse events (AEs), AEs leading to treatment discontinuation, abnormal physical examination findings of clinical relevance, abnormal vital signs of clinical relevance, abnormal electrocardiogram (ECG) parameters of clinical relevance, and changes in clinical safety laboratory parameters of clinical relevance
Endpoint(s): All-cause mortality and CV mortality, Change from Baseline in distance walked during the 6MWT (6MWD), Change from Baseline in KCCQ Overall Summary Score (KCCQ-OS), CV-related hospitalization, Change from baseline in TTR level (an in vivo measure of TTR stabilization), TTR stabilization measured in established ex vivo assays (FPE and D39Western blot) in the PK-PD substudy

Source: https://euclinicaltrials.eu/ctis-public/view/2024-515092-36-00